EU clinical trial 2024-515446-16-00: AN OPEN-LABEL, SINGLE-ARM, PHASE IB/IIA TRIAL TO EVALUATE THE SAFETY AND EFFICACY OF THE EP4 RECEPTOR ANTAGONIST VORBIPIPRANT (CR6086) IN COMBINATION WITH THE PD-1 INHIBITOR BALSTILIMAB (AGEN2034), IN PATIENTS WITH PRETREATED MISMATCH-REPAIR-PROFICIENT AND MICROSATELLITE STABLE METASTATIC COLORECTAL CANCER, AND OTHER METASTATIC GI CANCERS.
Protocol code: CR6086-1-04
Sponsor: Rottapharm Biotech S.r.l. (Pharmaceutical company). Phase: Phase I and Phase II (Integrated)- Other. Countries: Italy (ongoing, recruitment ended).
Therapeutic area(s): Diseases [C] - Neoplasms [C04]
Gender: Female, Male. Age: 18-64 years, 65+ years. Enrolment: 55.
Status: Ongoing, recruitment ended. Start date (EU): 2021-11-23. Decision date: 2024-08-12. Results received: No. Last updated: 2026-05-28.

Condition(s): Pretreated mismatch-repair-proficient and microsatellite stable metastatic colorectal cancer, and other metastatic GI cancers
Product: Balstilimab, CR6086, CR6086

Primary endpoint: Safety and tolerability: Incidence of DLTs (Main Study/Dose Escalation only only), Safety and tolerability: Incidence of Treatment Emergent Adverse Events (TEAEs) occurring while patients are on treatment or up to 30 days after the last dose of last study treatment, Safety and tolerability: Incidence of Serious Adverse Events (SAEs) occurring while patients are on treatment or up to 90 days after the last dose of last study treatment or to a minimum of 30 days after the last IMP intake in case of initiation of new anti-cancer therapy, whichever occurs first, Safety and tolerability: Changes in clinical laboratory parameters, vital signs, ECOG performance status, ECG and physical examination, Efficacy: DCR, defined as the proportion of patients who have achieved CR, PR, or stable disease (SD), Efficacy: ORR, defined as the proportion of patients who have achieved CR or PR
Endpoint(s): Exploratory: PD-L1 expression by CPS (Main Study/Expansion), Exploratory: Change in biomarkers in blood and tumour samples, Exploratory: Change in blood and tumour-infiltrating immune cells, Efficacy: DOR, defined as the time from first documentation of response (CR or PR) until the time of first documentation of disease progression, Efficacy: PFS, defined as the time from the first dose of study drugs to the earlier date of assessment of progression, or death by any cause in the absence of progression, Efficacy: PFSR, defined as the proportion of patients alive and free of disease progression at specific timepoints, Efficacy: OS, defined as the time from the first dose of study drugs to the date of death by any cause

Source: https://euclinicaltrials.eu/ctis-public/view/2024-515446-16-00